EU clinical trial 2023-507526-17-00: Impact of Multiple Doses of BAY63-2521 on Safety, Tolerability, Pharmacokinetics and Pharmacodynamics in Patients With Interstitial Lung Disease (ILD) Associated Pulmonary Hypertension (PH)
Protocol code: 12916
Sponsor: Bayer AG (Pharmaceutical company). Phase: Therapeutic exploratory (Phase II). Countries: Germany (ended).
Therapeutic area(s): Diseases [C] - Cardiovascular Diseases [C14]
Gender: Female, Male. Age: 18-64 years, 65+ years. Enrolment: 1.
Status: Ended. Start date (EU): 2008-05-13. End date (EU): 2025-07-03. Decision date: 2024-02-05. Results received: No. Last updated: 2025-04-17.

Condition(s): "Patients with interstitial lung disease associated pulmonary hypertension"

Source: https://euclinicaltrials.eu/ctis-public/view/2023-507526-17-00